EU clinical trial 2022-502077-42-00: A Phase 2/3, Randomized, Double-blind, Parallel-group, Placebo-controlled, Flexible-dose, Multicenter Study to Evaluate the Efficacy and Safety of SEP 363856 in the Treatment of Adults with Generalized Anxiety Disorder
Protocol code: SEP361-226
Sponsor: Otsuka Pharmaceutical Development & Commercialization Inc. (Pharmaceutical company). Phase: Phase II and Phase III (Integrated). Countries: Estonia (ended), Spain (ended), Finland (ended), Sweden (ended), Bulgaria (ended), Slovakia (ended).
Therapeutic area(s): Psychiatry and Psychology [F] - Mental Disorders [F03]
Gender: Female, Male. Age: 18-64 years, 65+ years. Enrolment: 255.
Status: Ended. Start date (EU): 2023-09-14. End date (EU): 2025-09-17. End date: 2025-09-26. Decision date: 2023-07-24. Results received: No. Last updated: 2025-08-29.
Decision dates by country: ES: 2023-07-25, BG: 2023-07-26, EE: 2023-07-28, FI: 2023-07-25, SK: 2023-07-24, SE: 2023-07-24

Condition(s): generalised anxiety disorder
Product: Ulotaront, Ulotaront, Ulotaront, Placebo SEP-365856

Primary endpoint: Change from Baseline in Hamilton Anxiety Rating Scale (HAM-A) total score at Endpoint.
Endpoint(s): Change from Baseline in Clinical Global Impression-Severity (CGI-S) score at Endpoint.

Source: https://euclinicaltrials.eu/ctis-public/view/2022-502077-42-00